EU clinical trial 2024-518734-87-00: Evaluation of the Effect of Itraconazole, Quinidine and Rifampicin on the Single-Dose Pharmacokinetics of ZED1227
Protocol code: CEC-012/BIO
Sponsor: Dr. Falk Pharma GmbH (Pharmaceutical company). Phase: Human Pharmacology (Phase I)- Other. Countries: Portugal (ended).
Therapeutic area(s): Not possible to specify
Gender: Female, Male. Age: 18-64 years. Enrolment: 32.
Status: Ended. Start date (EU): 2025-03-25. End date (EU): 2025-05-10. Decision date: 2025-03-17. Results received: No. Last updated: 2025-03-17.

Condition(s): No medical condition.

Source: https://euclinicaltrials.eu/ctis-public/view/2024-518734-87-00